EU clinical trial 2024-511195-33-00: AMG 193 in Combination with Other Therapies in Subjects with Advanced Gastrointestinal, Biliary Tract, or Pancreatic Cancers With Homozygous MTAP-deletion – Master Protocol
Protocol code: 20230223
Sponsor: Amgen Inc. (Pharmaceutical company). Phase: Human Pharmacology (Phase I)- Other. Countries: Denmark (ongoing, recruitment ended), Greece (ongoing, recruitment ended), France (ongoing, recruitment ended), Germany (ended), Belgium (ongoing, recruitment ended), Spain (ongoing, recruitment ended), Netherlands (ended), Italy (ongoing, recruitment ended).
Therapeutic area(s): Diseases [C] - Neoplasms [C04]
Gender: Male. Age: 18-64 years, 65+ years. Enrolment: 81.
Start date (EU): 2024-09-23. Decision date: 2024-08-28. Results received: No. Last updated: 2026-07-09.
Decision dates by country: DE: 2024-08-29, BE: 2024-09-02, DK: 2024-08-28, FR: 2024-08-28, ES: 2024-09-09, IT: 2024-09-09, GR: 2024-08-28, NL: 2024-08-28

Condition(s): Gastrointestinal tract, biliary tract, or pancreatic cancers with homozygous methylthioadenosine phosphorylase (MTAP)-deletion

Source: https://euclinicaltrials.eu/ctis-public/view/2024-511195-33-00